EU clinical trial 2023-509872-41-00: A Phase 1b study to investigate safety and tolerability of ARGX-119 in adult participants with DOK7 Congenital Myasthenic Syndrome (CMS)
Protocol code: ARGX-119-2302
Sponsor: Argenx (Pharmaceutical company). Phase: Phase I and Phase II (Integrated)- Other. Countries: Spain (ongoing, recruitment ended), Austria (ended), Italy (ongoing, recruitment ended), France (ongoing, recruitment ended).
Therapeutic area(s): Diseases [C] - Immune System Diseases [C20]
Gender: Female, Male. Age: 18-64 years, 65+ years. Enrolment: 10.
Start date (EU): 2024-09-24. Decision date: 2024-09-02. Results received: No. Last updated: 2026-07-22.
Decision dates by country: AT: 2024-09-02, FR: 2024-09-03, IT: 2024-09-03, ES: 2024-09-02

Condition(s): congenital neuromuscular disorders

Source: https://euclinicaltrials.eu/ctis-public/view/2023-509872-41-00